EU clinical trial 2024-519058-35-00: Implementation Study of Lipid Management of High-risk Cardiovascular Patients- Semmelweis Lipid Center for High-risk Patients
Protocol code: SLICK-001
Sponsor: Semmelweis University (Educational Institution). Phase: Therapeutic use (Phase IV). Countries: Hungary (ongoing, recruitment ended).
Therapeutic area(s): Diseases [C] - Cardiovascular Diseases [C14]; Diseases [C] - Nutritional and Metabolic Diseases [C18]
Gender: Female, Male. Age: 18-64 years, 65+ years. Enrolment: 200.
Status: Ongoing, recruitment ended. Start date (EU): 2023-05-30. Decision date: 2024-10-22. Results received: No. Last updated: 2024-10-22.

Condition(s): primary hypercholesterolaemia (heterozygous familial and non-familial) or mixed dyslipidaemia in atherosclerotic cardiovascular disease
Product: Leqvio 284 mg solution for injection in pre-filled syringe

Primary endpoint: absolute and percent change in LDL-level from first to last visit (mmol/L), absolute and percent LDL-change from visit to visit
Endpoint(s): change (from first to last visit) in percent of patients reaching LDL target (LDL<1.4 mmol/L), change in coronary CT paramteres (total plaque volumen; „low-attenuation" plaque volumen; Agatston score; plaque composition; pericoronarial and pericardial fat tissue), Ultrasound (femoral/carotid) endpoints: change in (from first to last visit): Total plaque area (mm2) Intima:media thickness plaque composition, change in BMI, Change in lifestyle, diet and health behaviour

Source: https://euclinicaltrials.eu/ctis-public/view/2024-519058-35-00